EU clinical trial 2024-515170-27-00: Evaluation of bioequivalence of two products containing 50 mg dimenhydrinate: Dimenhydrinate 50 mg (Test) vs. Vomex A 50 mg Lösung zum Einnehmen im Beutel (Comparator). A monocentric, open, randomized, single dose, two-period, crossover trial in healthy volunteers
Protocol code: CHE24001
Sponsor: CCDRD Cooperative Clinical Drug Research and Development AG, Hermes Pharma GmbH (Pharmaceutical company). Phase: Human Pharmacology (Phase I)- Bioequivalence Study. Countries: Bulgaria (ended).
Therapeutic area(s): Diseases [C] - Digestive System Diseases [C06]
Gender: Female, Male. Age: 18-64 years. Enrolment: 36.
Status: Ended. Start date (EU): 2024-11-15. End date (EU): 2024-12-11. Decision date: 2024-11-11. Results received: No. Last updated: 2024-11-11.

Condition(s): No therapeutic indication in the current trial with healthy volunteers.

Source: https://euclinicaltrials.eu/ctis-public/view/2024-515170-27-00